EU clinical trial 2024-519650-36-00: Evaluation of the effect of adrenalized lidocaine with or without bicarbonate on early postoperative recovery in ambulatory hand and foot surgery with WALANT: A Single-centre prospective randomised double-blind non-inferiority study.
Protocol code: LOCAL/2024/YG-01
Sponsor: Centre Hospitalier Universitaire De Nimes (Hospital/Clinic/Other health care facility). Phase: Therapeutic use (Phase IV). Countries: France (ongoing, recruiting).
Therapeutic area(s): Analytical, Diagnostic and Therapeutic Techniques and Equipment [E] - Anesthesia and Analgesia [E03]
Gender: Female, Male. Age: 18-64 years, 65+ years. Enrolment: 150.
Status: Ongoing, recruiting. Start date (EU): 2026-02-19. Decision date: 2025-09-02. Results received: No. Last updated: 2025-09-02.

Condition(s): Hand Surgery, Foot surgery
Product: BICARBONATE DE SODIUM 8,4% B. BRAUN, solution pour perfusion, CHLORURE DE SODIUM FRESENIUS 0,9 %, solution pour perfusion, XYLOCAINE 10 mg/ml ADRENALINE 0,005 mg/ml, solution injectable, XYLOCAINE 10 mg/ml ADRENALINE 0,005 mg/ml, solution injectable

Primary endpoint: Quality Of recovery score (QOR 15) at day 1
Endpoint(s): Complete sensory block from injection (in min), Re-injection of intraoperative local anaesthetic: yes/no., Pain score on initial injection of anaesthetic solution: Visual Numeric Scale (VNS) 0-10., Intraoperative pain score during surgery: Visual Numeric Scale (VNS) 0-10., Visual Numeric Scale (VNS) satisfaction at discharge from hospital from 0 to 10., VNS (0-10) pain score at D0, D1, D2, Quantity of analgesic taken postoperatively during the first 48 hours postoperatively, in particular weak and strong opioids, Duration of sensory-motor block release (in h)., Postoperative adverse events including haematoma, scar deunion, re-hospitalisation, surgical site infection

Source: https://euclinicaltrials.eu/ctis-public/view/2024-519650-36-00